EU clinical trial 2024-511048-22-00: HOVON 139 CLL: A prospective, open-label, multicenter randomized phase-II trial to evaluate the efficacy and safety of a sequential regimen of Gazyvaro (obinutuzumab) followed by obinutuzumab and venetoclax, followed by either standard venetoclax maintenance or MRD guided venetoclax maintenance in first-line patients with CLL and unfit for FCR-like regimens. (GIVE trial).
Protocol code: HO139
Sponsor: Hemato-Oncologie voor Volwassenen Nederland (Hovon) Stichting (Hospital/Clinic/Other health care facility). Phase: Therapeutic exploratory (Phase II). Countries: Netherlands (ended).
Therapeutic area(s): Diseases [C] - Neoplasms [C04]
Gender: Female, Male. Age: 18-64 years, 65+ years. Enrolment: 70.
Status: Ended. Start date (EU): 2016-10-27. End date (EU): 2025-08-21. Decision date: 2024-05-28. Results received: No. Last updated: 2024-05-28.

Condition(s): Chronic lymphocytic leukemia
Product: Venetoclax, Venetoclax, Venetoclax, Gazyvaro 1,000 mg concentrate for solution for infusion.

Primary endpoint: MRD negative bone marrow after maximum 24 cycles of (planned) venetoclax and no progression according to IWCLL criteria at any earlier timepoint
Endpoint(s): Efficacy as assessed by additional outcome measures, including overall response, PFS, EFS and OS, MRD in blood, Toxicity of venetoclax after pre-induction, especially tumorlysis and neutropenia, Quality of life, Geriatric assessment, P16 expression in skin biopsy, Predictive factors for response and resistance mechanisms: NGS at baseline and at progression, Predictive factors for response and resistance mechanisms: Flow-based subset analysis on expression levels of Bcl-2 proteins at baseline, during therapy and at progression, Predictive factors for response and resistance mechanisms: Analyses of malignant and non-malignant immune cells in PB and in LN at baseline and during treatment, Relationship between MRD dynamics and T cell diversity and/or function (amendment December 2021)

Source: https://euclinicaltrials.eu/ctis-public/view/2024-511048-22-00